EU clinical trial 2023-510317-26-00: A Phase 2, Randomized, Double-Blind, Placebo-Controlled, Parallel Study to Assess the Efficacy, Safety, Tolerability, PK, and Biomarker Effects of PTC857 in Adult Subjects With Amyotrophic Lateral Sclerosis (CARDINALS)
Protocol code: PTC857-CNS-001-ALS
Sponsor: PTC Therapeutics Inc. (Pharmaceutical company). Phase: Therapeutic exploratory (Phase II). Countries: Germany (ended), Italy (ended), Norway (ended), Ireland (ended), Sweden (ended), Spain (ended), Poland (ended), France (ended), Belgium (ended), Netherlands (ended), Czechia (ended).
Therapeutic area(s): Diseases [C] - Nervous System Diseases [C10]
Gender: Female, Male. Age: 18-64 years, 65+ years. Enrolment: 242.
Status: Ended. Start date (EU): 2023-02-07. End date (EU): 2024-11-26. Decision date: 2024-04-09. Results received: Yes. Last updated: 2024-12-10.
Decision dates by country: FR: 2024-04-12, NL: 2024-04-15, ES: 2024-04-09, IE: 2024-04-09, BE: 2024-04-22, PL: 2024-04-12, DE: 2024-04-12, CZ: 2024-04-10, IT: 2024-04-11, SE: 2024-04-10, NO: 2024-04-12

Condition(s): Amyotrophic Lateral Sclerosis
Product: PTC857, Placebo to match PTC857 60 mg/mL oral solution, Utreloxastat 62.5

Primary endpoint: The primary endpoint is subject ranks based on the combined assessment of ALS Functional Rating Scale-Revised (ALSFRS-R) and survival after 24 weeks of treatment in the Intent-to-Treat 1 (ITT1) Analysis Set
Endpoint(s): Change from baseline in ALSFRS-R in the ITT1 Analysis Set after 24 weeks of treatment, Safety and tolerability of PTC857 as measured by the severity and number of TEAEs and TESAEs, and change in clinical laboratory tests, physical examination, vital signs, Columbia-Suicide Severity Rating Scale (C-SSRS), and 12-lead electrocardiograms (ECGs) during the Treatment Period, Change from baseline in slow vital capacity as assessed by pulmonary function tests (PFTs) after 24 weeks of treatment, Change from baseline in motor/limb and bulbar function as assessed by the Modified Norris Scale after 24 weeks of treatment, Subject ranks based on the combined assessment of ALSFRS-R and survival after 24 weeks of treatment in the Intent-to-Treat 2 (ITT2) Analysis Set, Change from baseline in ALSFRS-R in the ITT2 Analysis Set after 24 weeks of treatment, Survival as assessed by rate of and length of time to death, Quality of life as assessed by ALSAQ-40 after 24 weeks of treatment, Change from baseline in plasma NfL activity after 24 weeks of treatment, Plasma PK and cerebrospinal fluid (CSF) exposure of PTC857

Source: https://euclinicaltrials.eu/ctis-public/view/2023-510317-26-00